EU clinical trial 2024-519156-93-00: TestICUs : Effects of early testosterone gel administration on physical performance in the critically ill: a randomised double blind clinical trial.
Protocol code: PHRC N2018 BACHOUMAS
Sponsor: University Hospital Of Clermont-Ferrand (Hospital/Clinic/Other health care facility). Phase: Therapeutic exploratory (Phase II). Countries: France (ongoing, recruiting).
Therapeutic area(s): Diseases [C] - Nutritional and Metabolic Diseases [C18]
Gender: Female, Male. Age: 18-64 years, 65+ years. Enrolment: 600.
Status: Ongoing, recruiting. Start date (EU): 2023-07-21. Decision date: 2024-12-30. Results received: No. Last updated: 2026-06-29.

Condition(s): Invasive mechanical ventilation expected to be required for more than 48 hours
Product: TESTOGEL, ANDROGEL 16,2 mg/g, gel

Primary endpoint: • Physical performance 3 months after ICU admission assessed by the 6-minute-walk distance test (6MWD) in metres. Absolute values will be compared to show a minimum absolute difference of 30 meters
Endpoint(s): Physical performance 3, 6 months and 1 year after ICU admission : 6 MWD at 6 months and 1 year, Percentage of patients with Short Physical Performance Battery < 10 at 3, 6 months and 1 year, Physical component of SF 36 (Medical Outcomes Study 36 Item Short Form Health Survey) at 3, 6 months and 1 year, Muscle strength on ICU discharge at 3, 6 months and 1 year after ICU admission: - Handgrip: Kg and percentage of the predicted force, - MRC, Muscle mass at 3, 6 and 1 year after ICU admission : MAMC, Functional status at 3, 6 months and 1 year after ICU admission : - Composite score of 11 items of ADL and IADL, Oxygen muscular consumption at ICU discharge and at 3 months after ICU admission, Ventilation free days at day 28, Length of stay in the ICU, Length of stay in hospital, Mortality rate at day 28, Mortality rate at day 90, ICU mortality rate, Hospital mortality rate, Safety of testosterone gel : - Hypertension, - Cardiovascular events, - Obstructive sleep apnea, - Increase in hemoglobin, hematocrit and red blood cells counts, - Alopecia, urticaria, acne, erythema, - Vertigo, paresthesia, - Depression, anxiety, - Gynaecomastia, - Oedema, weight gain, - insulin requirements, - Fractures

Source: https://euclinicaltrials.eu/ctis-public/view/2024-519156-93-00